EU clinical trial 2023-506257-37-00: A Multi-center, Randomized, Double-blind, Placebo-controlled Phase 3 Study to Evaluate the Efficacy and Safety of Deucravacitinib in Participants with Active Psoriatic Arthritis (PsA) who are Naïve to Biologic Disease Modifying Anti-rheumatic Drugs or had Previously Received TNFα Inhibitor Treatment
Protocol code: IM011-055
Sponsor: Bristol-Myers Squibb Services Unlimited Company (Pharmaceutical company). Phase: Therapeutic confirmatory (Phase III). Countries: Czechia (ongoing, recruitment ended), Germany (ongoing, recruitment ended), Belgium (ongoing, recruitment ended), Hungary (ongoing, recruitment ended), Spain (ongoing, recruitment ended), Poland (ongoing, recruitment ended).
Therapeutic area(s): Diseases [C] - Immune System Diseases [C20]
Gender: Female, Male. Age: 18-64 years, 65+ years. Enrolment: 360.
Status: Ongoing, recruitment ended. Start date (EU): 2021-10-29. Decision date: 2023-12-07. Results received: No. Last updated: 2026-05-18.
Decision dates by country: PL: 2024-02-23, BE: 2023-12-11, ES: 2023-12-11, DE: 2023-12-08, CZ: 2023-12-07, HU: 2023-12-08

Condition(s): Active Psoriatic Arthritis
Product: Placebo to match Apremilast film-coated tablets, deucravacitinib, Placebo to match deucravacitinib tablet, Otezla 10mg, 20mg, 30 mg film-coated tablets

Primary endpoint: Proportion of participants meeting American College of Rheumatology improvement of 20% (ACR20)
Endpoint(s): Change from baseline in DAS28-CRP score at Week 16, Change from baseline in HAQ-DI score at Week 16, Proportion of participants meeting PASI 75 response at Week 16, in participants with at least 3% BSA involvement AND at least sPGA 2 at baseline, Change from baseline in the SF-36 PCS score at Week 16, Proportion of participants meeting enthesitis resolution (score of 0) among participants with enthesitis at baseline by LEI at Week 16, Proportion of participants meeting achievement of MDA where an MDA response is achievement of 5 of 7 following outcomes at Week 16: a) Tender joint count ≤ 1 b) Swollen joint count ≤ 1 c) PASI ≤ 1 or BSA ≤ 3% d) Patient assessment of PsA pain ≤ 15 e) Patient Global Assessment of PsA disease activity ≤ 20 f) HAQ-DI ≤ 0.5 g) Tender enthesial points ≤ 1, Change from baseline in FACIT-Fatigue score at Week 16, Proportion of participants meeting dactylitis resolution at Week 16 among the participants with dactylitis at baseline, where resolution is defined as a tender dactylitis count of 0 in participants with a tender dactylitis count ≥ 1 at baseline

Source: https://euclinicaltrials.eu/ctis-public/view/2023-506257-37-00